EU clinical trial 2022-501084-41-00: Xerostomia in patients with a life-limiting condition or frailty: a double-blind placebo-controlled randomized clinical trial
Protocol code: 2022-501084-41-00
Sponsor: University Hospital Maastricht (Hospital/Clinic/Other health care facility). Phase: Therapeutic confirmatory (Phase III). Countries: Netherlands (ended).
Therapeutic area(s): Not possible to specify
Gender: Female, Male. Age: 18-64 years, 65+ years. Enrolment: 120.
Status: Ended. Start date (EU): 2024-03-05. End date (EU): 2025-04-28. Decision date: 2023-03-21. Results received: Yes. Last updated: 2024-08-27.

Condition(s): Adult patients with a life-limiting condition or frailty who have the complaint dry mouth
Product: PILOCARPINE HYDROCHLORIDE

Primary endpoint: The main trial endpoint is the percentage responders at week 4 of topical pilocarpine administration (3x 6 oral drops of pilocarpine per day) for which a clinically relevant response is defined as at least a 2-point reduction on the 11-point NRS, as compared to baseline.
Endpoint(s): Mean difference in NRS dry mouth scores in the pilocarpine group at all time-points compared to placebo, Percentage responders at week 8 and 12 among all patients who started with off-label, compassionate use of pilocarpine drops and who stopped the use of pilocarpine drops at week 4, Mean difference in severity of xerostomia as measured with the xerostomia inventory scale (sXI) in the pilocarpine group at all time-points compared to placebo, The Global Perceived Effect (GPE) of the use of pilocarpine drops at t= 2, t= 4, t= 8 and t = 12, when compared to the placebo group, Change in Oral Health-Related quality of life (OHRQoL) measured with the Geriatric Oral Health Assessment Index (GOHAI-NL) upon pilocarpine treatment at all time-points, when compared to the placebo group, Change in Health-Related Quality of Life (HRQoL) measured with the EQ-5D-5L questionnaire upon pilocarpine treatment at t = 0, t = 4, t = 8, and t = 12, when compared to the placebo group, Change in Patient-Reported Functional Status (PRFS) upon pilocarpine treatment at all time-points, The durability of the effect of the use of pilocarpine drops at week 8 and 12 on xerostomia, Possible side effects related to the intake of pilocarpine medication, measured from week 2 (t = 2, t = 4, t = 8, t = 12 weeks), The adherence rate of patients, measured at t = 2, t = 4, t = 8, t = 12 weeks, Patients’ views on applicability of pilocarpine to reduce complaints of dry mouth, measured at t = 4, t = 8, t = 12 weeks, The cost-effectiveness of pilocarpine treatment, measured at t = 0, t = 4, t = 8, t = 12 weeks

Source: https://euclinicaltrials.eu/ctis-public/view/2022-501084-41-00